EU clinical trial 2023-505249-24-00: Phase III Study of Trastuzumab Deruxtecan (T-DXd) with or without Pertuzumab versus Taxane, Trastuzumab and Pertuzumab in HER2-positive, First-line Metastatic Breast Cancer (DESTINY-Breast09)
Protocol code: D967UC00001
Sponsor: AstraZeneca AB (Pharmaceutical company). Phase: Therapeutic confirmatory (Phase III). Countries: Sweden (ongoing, recruitment ended), Germany (ongoing, recruitment ended), Belgium (ongoing, recruitment ended), Denmark (ongoing, recruitment ended), Spain (ongoing, recruitment ended), France (ongoing, recruitment ended), Romania (ongoing, recruitment ended), Italy (ongoing, recruitment ended), Hungary (ongoing, recruitment ended).
Therapeutic area(s): Diseases [C] - Neoplasms [C04]
Gender: Female, Male. Age: 18-64 years, 65+ years. Enrolment: 143.
Status: Ongoing, recruitment ended. Start date (EU): 2021-05-27. Decision date: 2024-05-16. Results received: No. Last updated: 2026-02-16.
Decision dates by country: DK: 2024-05-16, SE: 2024-05-21, DE: 2024-05-22, BE: 2024-06-03, ES: 2024-06-04, RO: 2024-05-24, HU: 2024-06-03, FR: 2024-05-22, IT: 2024-05-29

Condition(s): HER2-positive metastatic breast cancer
Product: Placebo (Saline 0.9% (weight per volume; w/v)) for Pertuzumab, PERTUZUMAB, TRASTUZUMAB, PACLITAXEL, DS-8201a, DOCETAXEL

Primary endpoint: PFS is defined as the time from date of randomisation until the date of objective radiological disease progression according to BICR using RECIST 1.1 or death by any cause.
Endpoint(s): PFS is defined as the time from date of randomisation until the date of objective radiological disease progression according to investigator assessment using RECIST 1.1 or death by any cause., OS is defined as the time from randomisation until the date of death due to any cause., ORR is defined as the proportion of participants who have a CR or PR, as determined by BICR and investigator assessment per RECIST 1.1. DoR is defined as the time from date of first detection of objective response until the date of objective radiological disease progression according to BICR and investigator assessment using RECIST 1.1 or death in the absence of progression., Time to second progression or death (PFS2) by Investigator assessment, Health related quality of life (HRQoL) using the European Organisation for Research and Treatment of Cancer (EORTC), Serum concentration of trastuzumab deruxtecan and pertuzumab, Immunogenicity of trastuzumab deruxtecan, alone or with pertuzumab., Safety and tolerability of trastuzumab deruxtecan, alone or with pertuzumab

Source: https://euclinicaltrials.eu/ctis-public/view/2023-505249-24-00